EU clinical trial 2023-504366-36-00: Weaning protocol for high-flow nasal oxygen therapy in the ICU - Multicenter randomized controlled trial. HiFloWEAN
Protocol code: DR230001
Sponsor: Centre Hospitalier Regional Universitaire De Tours (Hospital/Clinic/Other health care facility). Phase: Therapeutic confirmatory (Phase III). Countries: France (ongoing, recruiting).
Therapeutic area(s): Diseases [C] - Respiratory Tract Diseases [C08]
Gender: Female, Male. Age: 18-64 years, 65+ years. Enrolment: 370.
Status: Ongoing, recruiting. Start date (EU): 2024-02-17. Decision date: 2023-09-19. Results received: No. Last updated: 2026-04-27.

Condition(s): de novo acute respiratory failure
Product: OXYGENE MEDICINAL LIQUIDE AIR LIQUIDE SANTE FRANCE, gaz pour inhalation, pour évaporateur fixe

Primary endpoint: The primary endpoint was the success rate at D7, with success defined as "definitive" weaning from high-flow nasal oxygen therapy, i.e. patients weaned for more than 48 hours from high-flow nasal oxygen therapy without recourse to non-invasive ventilation or intubation and alive at D7.
Endpoint(s): Weaning rate from high-flow nasal oxygen therapy at D28, Time to definitive weaning from high-flow nasal oxygen therapy between randomization and D28, Cumulative incidence of intubation up to D28, Cumulative incidence of curative non-invasive ventilation up to D28, Mortality rate at D28, Number of days on high-flow nasal oxygen therapy in patients permanently weaned from high-flow nasal oxygen therapy between randomization and discharge from intensive care or at D28, Evolution of ROX index during weaning phase, Evolution of accessory respiratory muscle engagement by Patrick score, Progression of dyspnoea assessed by the modified Borg scale, Length of stay in intensive care and/or continuous care unit, Duration of stay between admission to the intensive care and/or continuous monitoring unit and discharge from intensive care OR the ability to be discharged from intensive care assessed through an aptitude assessment grid. The ability to be discharged from intensive care/continuous monitoring will be defined by the validation of all items on the modified aptitude assessment grid (see appendix).

Source: https://euclinicaltrials.eu/ctis-public/view/2023-504366-36-00